EU clinical trial 2023-507268-37-00: A Phase 3, Randomized, Double-Blind, Placebo-Controlled, Crossover Study of Oral Deucrictibant Soft Capsule for On-Demand Treatment of Attacks in Adolescents and Adults with Hereditary Angioedema.
Protocol code: PHA022121-C306
Sponsor: Pharvaris Netherlands B.V. (Pharmaceutical company). Phase: Therapeutic confirmatory (Phase III). Countries: Poland (ended), Germany (ended), Austria (ended), Italy (ended), Sweden (ended), Bulgaria (ended), Ireland (ended), Hungary (ended), Spain (ended), Netherlands (ended), Czechia (ended), France (ended), Slovakia (ended), Romania (ended).
Therapeutic area(s): Diseases [C] - Immune System Diseases [C20]; Phenomena and Processes [G] - Immune system processes [G12]
Gender: Female, Male. Age: 0-17 years, 18-64 years, 65+ years. Enrolment: 73.
Status: Ended. Start date (EU): 2024-07-29. End date (EU): 2025-10-15. End date: 2025-10-17. Decision date: 2024-07-16. Results received: Yes. Last updated: 2025-09-16.
Decision dates by country: FR: 2024-11-04, IT: 2024-07-19, RO: 2024-10-07, AT: 2024-09-09, SE: 2024-09-04, BG: 2024-07-23, IE: 2024-08-09, PL: 2024-07-22, HU: 2024-09-13, DE: 2024-07-25, CZ: 2024-10-31, SK: 2024-10-30, ES: 2024-10-28, NL: 2024-10-28

Condition(s): Hereditary Angioedema
Product: Deucrictibant (PHA-022121), ICATIBANT, Placebo matches Deucritibant soft capsules with exception of active substance.

Primary endpoint: Time to onset of symptom relief, defined as Patient Global Impression of Change (PGI-C) rating of at least “a little better” for 2 consecutive timepoints within 12 hours post-treatment.
Endpoint(s): 1. Proportion of study drug-treated attacks achieving PGI-C rating of at least “a little better” at 4 hours post-treatment, 2. Time to substantial symptom relief, defined as achieving PGI-C rating of at least “better” for 2 consecutive timepoints within 12 hours post-treatment., 3. Time to substantial symptom relief by Patient Global Impression of Severity (PGI-S), defined as achieving ≥1 point reduction in PGI-S from pre-treatment for 2 consecutive timepoints within 12 hours post-treatment., 4. Time to complete symptom resolution, defined as achieving PGI-S rating of “none” within 48 hours post-treatment., 5. Time to End of Progression (EoP) in attack symptoms within 12 hours, with EoP time defined as the earliest post-treatment timepoint after which all subsequent PGI-C ratings are stable or improved., 6. Proportion of study drug-treated attacks requiring rescue medication within 24 hours post treatment., 7. Proportion of attacks achieving symptom resolution, defined as achieving PGI-S rating of “none” with one dose of study drug at 24 hours post-treatment., 8. Time to substantial symptom relief by Angioedema SyMptom Rating scAle (AMRA), defined as a ≥50% reduction in AMRA composite score from pre-treatment for 2 consecutive timepoints within 12 hours post-treatment., 9. Time to almost complete or complete symptom relief by AMRA, defined as all item scores in AMRA having a value ≤10 for 2 consecutive timepoints within 24 hours post-treatment., 10. Proportion of study drug-treated attacks reaching almost complete or complete symptom relief by AMRA, defined as all item scores in AMRA having a value ≤10 at 24 hours post treatment., 11. Time to EoP in attack symptoms within 12 hours, with EoP time defined as the earliest post-treatment timepoint after which every individual AMRA item is stable or improved at all subsequent timepoints

Source: https://euclinicaltrials.eu/ctis-public/view/2023-507268-37-00